EU clinical trial 2024-513590-45-00: A study in healthy people to test how 2 different formulations of BI 690517 are taken up in the body and how probenecid influences the amount of BI 690517 in the blood
Protocol code: 1378-0025
Sponsor: Boehringer Ingelheim International GmbH (Industry). Phase: Human Pharmacology (Phase I)- Other. Countries: Germany (ended).
Therapeutic area(s): Not possible to specify
Gender: Female, Male. Age: 18-64 years. Enrolment: 15.
Status: Ended. Start date (EU): 2024-11-12. End date (EU): 2025-01-07. Decision date: 2024-09-11. Results received: No. Last updated: 2024-09-11.

Condition(s): Healthy volunteer trial

Source: https://euclinicaltrials.eu/ctis-public/view/2024-513590-45-00